EU clinical trial 2023-510247-38-00: RANDOMIZED, DOUBLE-BLIND, PLACEBO-CONTROLLED, MULTIPLE ASCENDING DOSE STUDY TO EVALUATE THE SAFETY, TOLERABILITY, PHARMACOKINETICS, AND PHARMACODYNAMICS OF IA-14069 IN HEALTHY SUBJECTS, WITH AN EXTENSION TO EXPLORE ANY DRUG-DRUG INTERACTION POTENTIAL WITH METHOTREXATE (PART 1), AND IN PATIENTS WITH RHEUMATOID ARTHRITIS, WITH PRELIMINARY ASSESSMENT OF EFFICACY IN PATIENTS (PART 2)
Protocol code: IA-14069_1b
Sponsor: Ilab Co. Ltd. (Laboratory/Research/Testing facility). Phase: Human Pharmacology (Phase I)- Other. Countries: Romania (ended).
Therapeutic area(s): Diseases [C] - Immune System Diseases [C20]
Gender: Female, Male. Age: 18-64 years, 65+ years. Enrolment: 35.
Status: Ended. Start date (EU): 2024-06-07. End date (EU): 2025-10-15. Decision date: 2024-05-24. Results received: No. Last updated: 2025-09-17.

Condition(s): Rheumatoid arthritis

Source: https://euclinicaltrials.eu/ctis-public/view/2023-510247-38-00